EU clinical trial 2024-511504-17-00: ARGX-113-1803: A Phase 3, Multicenter, Open-label, Long-term Trial to Evaluate the Safety and Efficacy of Efgartigimod (ARGX-113) 10 mg/kg Intravenous in Adult Patients With Primary Immune Thrombocytopenia
Protocol code: ARGX-113-1803
Sponsor: Argenx (Pharmaceutical company). Phase: Therapeutic confirmatory (Phase III). Countries: Italy (ended), Czechia (ended), Poland (ended), Hungary (ended).
Therapeutic area(s): Diseases [C] - Immune System Diseases [C20]
Gender: Female, Male. Age: 18-64 years, 65+ years. Enrolment: 6.
Status: Ended. Start date (EU): 2020-12-15. End date (EU): 2025-12-12. End date: 2026-03-11. Decision date: 2024-05-06. Results received: No. Last updated: 2026-01-12.
Decision dates by country: CZ: 2024-05-07, HU: 2024-05-06, IT: 2024-05-13, PL: 2024-05-16

Condition(s): Primary immune thrombocytopenia
Product: ARGX-113

Primary endpoint: Frequency and severity of AEs, vital signs, and laboratory assessments.
Endpoint(s): First 52-week treatment period only: 1. Extent of disease control defined as the percentage of weeks in the trial with platelet counts of ≥50×10^9/L., First 52-week treatment period only: Percentage of patients with overall platelet count response defined as achieving a platelet count of ≥50×10^9/L on at least 4 occasions at any time during the 52-week treatment period., First 52-week treatment period only: Mean change from baseline in platelet count at each visit., First 52-week treatment period only: For patients rolling-over from the ARGX-113-1801 trial with a platelet count of <30×10^9/L: time to response is defined as the time to achieve 2 consecutive platelet counts of ≥50×10^9/L., First 52-week treatment period only: The percentage of weeks in the trial with platelet counts of ≥ 30×10^9/L and at least 20×10^9/L above baseline., First 52-week treatment period only: In patients with baseline platelet count of <15×10^9/L in the current trial (ARGX-113-1803), the percentage of weeks in the trial with platelet counts of ≥30×10^9/L and at least 20×10^9/L above baseline., First 52-week treatment period only: In patients with first exposure to efgartigimod: proportion of patients who achieve a sustained platelet response defined as achieving platelet counts of at least 50×10^9/L for at least 4 of the 6 visits between week 19 and 24 of the trial., First 52-week treatment period only: In patients with first exposure to efgartigimod: proportion of patients in the overall population achieving platelet counts of at least 50×10^9/L for at least 6 of the 8 visits between week 17 and 24 of the trial., First 52-week treatment period only: Rate of receipt of rescue therapy (rescue per patient per month)., First 52-week treatment period only: Reduction in concurrent ITP therapy., First 52-week treatment period only: Incidence and severity of the WHO-classified bleeding events., First 52-week treatment period only: Change from baseline in PRO (FACIT-Fatigue, Fact-Th6) and QoL (SF- 36) at planned visits., First 52-week treatment period only: Pharmacokinetic parameter of efgartigimod: serum concentration observed predose (Ctrough)., First 52-week treatment period only: Pharmacodynamics markers: total IgG., First 52-week treatment period and additional 52-week treatment periods: Incidence of anti-drug antibodies (ADA) to efgartigimod.

Source: https://euclinicaltrials.eu/ctis-public/view/2024-511504-17-00